EU clinical trial 2023-509801-59-00: B7981032 - A PHASE 3 OPEN-LABEL, MULTI-CENTER, LONG-TERM STUDY INVESTIGATING THE SAFETY AND EFFICACY OF PF-06651600 IN ADULT AND ADOLESCENT PARTICIPANTS WITH ALOPECIA AREATA
Protocol code: B7981032
Sponsor: Pfizer Inc. (Pharmaceutical company). Phase: Therapeutic confirmatory (Phase III). Countries: Germany (ended), Spain (ended), Poland (ended), Czechia (ended).
Therapeutic area(s): Diseases [C] - Immune System Diseases [C20]
Gender: Female, Male. Age: 0-17 years, 18-64 years, 65+ years. Enrolment: 162.
Status: Ended. Start date (EU): 2020-07-09. End date (EU): 2024-11-11. End date: 2026-02-26. Decision date: 2024-06-11. Results received: No. Last updated: 2024-06-14.
Decision dates by country: CZ: 2024-06-14, DE: 2024-06-13, ES: 2024-06-11, PL: 2024-06-14

Condition(s): Alopecia areata
Product: Ritlecitinib tosilate, Ritlecitinib Tosilate

Primary endpoint: Through the time the last participant completes the Follow-up visit or 28 days after the Month 36 visit: 1) Incidence of treatment emergent adverse events (TEAEs); 2) Incidence of serious adverse events (SAEs) and adverse events (AEs) leading to discontinuation; 3) Incidence of clinically significant abnormalities in vital signs; 4) Incidence of clinically significant abnormalities in clinical laboratory values.
Endpoint(s): •Incidence of TEAEs; •Incidence of SAEs and AEs leading to discontinuation; •Incidence of clinically significant abnormalities in vital signs; •Incidence of clinically significant abnormalities in clinical laboratory values. •Response based on achieving absolute Severity of Alopecia Tool (SALT) score ≤10 through month 36, for overall and AA SALT score;

Source: https://euclinicaltrials.eu/ctis-public/view/2023-509801-59-00